EU clinical trial 2023-508280-69-00: A Phase 1 Study of BMS-986406 as Monotherapy and in Combination in Advanced Tumors
Protocol code: CA111-001
Sponsor: Bristol Myers Squibb International Corporation (Pharmaceutical company). Phase: Human Pharmacology (Phase I)- First administration to humans. Countries: Spain (ended), Belgium (ended).
Therapeutic area(s): Diseases [C] - Neoplasms [C04]
Gender: Female, Male. Age: 18-64 years, 65+ years. Enrolment: 27.
Status: Ended. Start date (EU): 2022-10-07. End date (EU): 2024-08-16. End date: 2024-08-17. Decision date: 2024-01-09. Results received: No. Last updated: 2024-04-25.
Decision dates by country: BE: 2024-01-18, ES: 2024-01-09

Condition(s): Advanced Malignant Tumors

Source: https://euclinicaltrials.eu/ctis-public/view/2023-508280-69-00